EU clinical trial 2023-508607-20-00: A Phase 3 Randomized, Placebo-controlled, Double-blind Study of Apalutamide Plus Androgen Deprivation Therapy (ADT) Versus ADT in Subjects with Metastatic Hormonesensitive Prostate Cancer (mHSPC)
Protocol code: 56021927PCR3002
Sponsor: Janssen Cilag International (Pharmaceutical company). Phase: Therapeutic confirmatory (Phase III). Countries: Czechia (ongoing, recruitment ended), Spain (ended), Romania (ongoing, recruitment ended).
Therapeutic area(s): Diseases [C] - Neoplasms [C04]
Gender: Male. Age: 18-64 years, 65+ years. Enrolment: 7.
Start date (EU): 2015-11-27. Decision date: 2024-03-01. Results received: No. Last updated: 2026-03-20.
Decision dates by country: RO: 2024-03-04, ES: 2024-03-01, CZ: 2024-03-01

Condition(s): Metastatic Hormone-sensitive Prostate Cancer
Product: Apalutamide placebo, JNJ-56021927

Primary endpoint: Radiographic Progression-Free Survival (rPFS), Overall Survival (OS)
Endpoint(s): Time to Pain Progression, Time to Skeletal-Related Event (SRE), Time to Chronic Opioid Use, Time to Initiation of Cytotoxic Chemotherapy

Source: https://euclinicaltrials.eu/ctis-public/view/2023-508607-20-00